EU clinical trial 2024-518007-22-00: A Phase III Randomised, Open Label Trial of an Intradermal or Subcutaneous booster dose of MVA-BN Vaccine to Investigate MPXV Immunogenicity and Safety for Protection Against Mpox in an Intradermally or Subcutaneously Primary Vaccinated Population – an adaptive protocol and a Non-Randomised Trial of a Subcutaneous Booster Dose for Subcutaneously Primary Vaccinated
Sponsor: The Public Health Agency Of Sweden (Laboratory/Research/Testing facility). Phase: Therapeutic confirmatory (Phase III). Countries: Sweden (ongoing, recruitment ended), France (authorised, recruitment pending), Ireland (ongoing, recruiting), Belgium (ongoing, recruiting).
Therapeutic area(s): Diseases [C] - Virus Diseases [C02]
Gender: Female, Male. Age: 18-64 years, 65+ years. Enrolment: 665.
Start date (EU): 2025-12-05. Decision date: 2025-01-27. Results received: No. Last updated: 2026-06-04.
Decision dates by country: FR: 2025-02-07, SE: 2025-01-27, BE: 2026-03-10, IE: 2025-02-14

Condition(s): Prevention of monkeypox (mpox) infection
Product: MODIFIED VACCINIA ANKARA – BAVARIAN NORDIC LIVE VIRUS, MODIFIED VACCINIA ANKARA – BAVARIAN NORDIC LIVE VIRUS

Primary endpoint: Non-inferiority (max 10% difference) between ID and SC booster arms, in detectable MPXV- and vaccinia virus-binding antibodies (BAbs) at 1 month (M1) post-booster assuming that at least 80% (and not <70%) of participants in both booster arms will have detectable BAbs.
Endpoint(s): Non-inferiority (max 10% difference) between ID and SC booster arms, in detectable MPXV- and vaccinia virus binding antibodies (BAbs) at 6 months post-booster assuming that 80% (and not <70%) of participants in both booster arms will have detectable BAbs., Compare MPXV and Vaccinia virus-specific humoral response between ID booster arm vs control, and SC booster arm vs control at M1 and M6 post-inclusion, using: • Geometric mean titers (GMTs) of MPXV- and Vaccinia-specific microneutralizing (NAbs) and MPXV- and vaccinia virus-binding antibodies (BAbs) • Change in sero-response rates (%, SRRs) in detectable antibodies (Nabs or Babs), Compare the humoral response (GMT, rate of decay from peak and % with detectable neutralizing and binding antibodies (NAbs and BAbs) by route of administration (Booster-ID vs Booster-SC) over time assessed at D0, D7 (for the participants in the sub-study), M1, M3, M6, M12 and M24 using: • GMTs of MPXV- and vaccinia virus binding antibodies and MPXV- & Vaccinia virus-specific microneutralisation antibodies • SRRs (% detectable antibodies from Day 0 forward up to M24., In a subgroup of participants assess and compare • the number, diversity, and functionality of MPXV- and MVA-BN specific memory plasma cells and B cells by study arm, at D0, D7, M1, M3, M6, M24. • Proportion of T-cells (CD4 and CD8) with detectable interferon and/or IL-2 production after stimulation by Mpox and/or MVA-BN antigens, assessed by ELISpot (triplicates) • Levels of detectable interferon and/or IL-2 production in T-cells (CD4 and CD8), assessed by ELISpot (Triplicates), In a subgroup of participants: assess and compare oral and rectal mucosa IgA and IgG antibody response (ELISA MSD) at D0, D7, M1, M3, M6, M24 using: • GMTs of mucosal MPXV- and vaccinia virus-specific binding antibodies • MPXV- and vaccinia virus-specific binding mucosal SRRs (>2-fold increase from Day 0 • Proportion of responders (% with detectable antibodies (NAbs and/or BAbs) by route of administration, Incidence and relationship of non-serious and serious adverse reactions (SARs) throughout (M24)., Cumulative incidence and clinical presentation of breakthrough infections defined as notified (serologically or PCR-confirmed) MPXV infections by study arm, Non-inferiority (max 10% difference) between an alternative vaccine and ID and SC MVA-BN booster arms (given that these are non-inferior to each other ie less than 10% difference), in detectable MPXV- and VACV- BAbs at M1 post-booster assuming that at least 80% (and not <70%) of participants in both booster arms will have detectable BAbs.

Source: https://euclinicaltrials.eu/ctis-public/view/2024-518007-22-00